EU clinical trial 2025-521559-22-00: Pre- and post-treatment evaluation of lung function with Xenon-gas enhanced Dual-Energy CT-imaging in patients undergoing radiotherapy
Sponsor: UZ Brussel (Hospital/Clinic/Other health care facility). Phase: Phase II and Phase III (Integrated). Countries: Belgium (authorised, recruitment pending).
Therapeutic area(s): Analytical, Diagnostic and Therapeutic Techniques and Equipment [E] - Diagnosis [E01]
Gender: Female, Male. Age: 18-64 years, 65+ years. Enrolment: 40.
Status: Authorised, recruitment pending. Decision date: 2025-10-22. Results received: No. Last updated: 2026-02-05.

Condition(s): Radiation-induced lung injury (radiation fibrosis, radiation pneumonitis), Lung and breast cancer
Product: Messer mixture 30 Vol% Xe in 70 Vol% O2

Primary endpoint: The primary endpoint of this study is to quantify radiotherapy-induced functional and anatomical changes by comparing pre- and post-treatment ventilation maps. Radiotherapy-induced changes will be assessed both qualitatively, by visual analysis of differences in lung parenchyma structure and ventilation patterns (hypo- or hyperdense areas on colour coded Xe-concentration maps of the lungs), and quantitatively, by computing local differences in ventilation metrics between pre- and post-treatment.
Endpoint(s): The secondary endpoint of this trial is to perform an extensive evaluation on the effect of RT on the lung parenchyma of lung- and breast cancer patients using ventilation metrics derived using a gas mixture of 30Vol% Xe in 70Vol% O2 as contrast agent combined with DECT.

Source: https://euclinicaltrials.eu/ctis-public/view/2025-521559-22-00